EU clinical trial 2024-513897-23-00: REFLECT; Real-time targeted fluorescence endoscopy for detection of the primary cancer lesion in patients with a metastasis of unknown primary tumor in the head and neck
Protocol code: 10949
Sponsor: Universitair Medisch Centrum Groningen (Hospital/Clinic/Other health care facility). Phase: Therapeutic exploratory (Phase II). Countries: Netherlands (ongoing, recruitment ended).
Therapeutic area(s): Analytical,Diagnostic,Therapeutic Techniques and Equipment [E]-Surgical Procedures, Operative [E04]; Diseases [C] - Neoplasms [C04]
Gender: Female, Male. Age: 18-64 years, 65+ years. Enrolment: 35.
Status: Ongoing, recruitment ended. Start date (EU): 2024-11-08. Decision date: 2024-11-08. Results received: No. Last updated: 2024-11-08.

Condition(s): Unknown primary tumour of the head and neck
Product: Erbitux 5 mg/mL solution for infusion

Primary endpoint: Macroscopic fluorescent signal levels and tracer distribution observed with TFE, Detection rates of TFE and WLE
Endpoint(s): Patient characteristics (age, sex, BMI, history and morbidity, localization of primary tumor and lymph node metastasis, vital parameters and presence of symptoms before and after tracer administration), Macroscopic fluorescent signal levels and tracer distribution observed with flexible fluorescence laryngoscopy, Quantification of intrinsic fluorescence signals observed using the MDSFR/SFF probe, Macroscopic fluorescent signal levels and tracer distribution observed with ex vivo imaging of FSA and mucosectomy specimens, Histopathologic characteristics of biopsied specimens including HPV-status, Results of the quality of life questionnaires QLQ-C30, QLQH&N35 and SWAL-QOL

Source: https://euclinicaltrials.eu/ctis-public/view/2024-513897-23-00